EU clinical trial 2023-503336-41-00: BESTOW: A Phase 2, Multicenter, Randomized, Open-Label Study to Evaluate the Safety and Efficacy of Tegoprubart in Patients Undergoing Kidney Transplantation
Protocol code: AT-1501-K207
Sponsor: Eledon Pharmaceuticals Inc. (Pharmaceutical company). Phase: Therapeutic exploratory (Phase II). Countries: Spain (ended), France (ended), Germany (ended).
Therapeutic area(s): Phenomena and Processes [G] - Immune system processes [G12]
Gender: Female, Male. Age: 18-64 years. Enrolment: 101.
Status: Ended. Start date (EU): 2023-11-29. End date (EU): 2025-08-26. End date: 2025-09-25. Decision date: 2023-10-30. Results received: No. Last updated: 2025-07-22.
Decision dates by country: ES: 2023-10-30, FR: 2023-11-02, DE: 2023-11-02

Condition(s): Prophylaxis of Renal Allograft Rejection
Product: Prograf 5 mg/ml concentrate for solution for infusion, CellCept 250 mg capsules, CellCept 250 mg capsules, Myfortic 360 mg gastro-resistant tablets, CellCept 500 mg film-coated tablets, Myfortic 180 mg gastro-resistant tablets, CellCept 1 g/5 ml powder for oral suspension, Prograf 0.5 mg hard capsules, CellCept 500 mg film-coated tablets, Prograf 1 mg hard capsules, AT-1501 475 mg Vial, Thymoglobuline 25mg Powder for Solution for Infusion, Prednisolone 5 mg Tablets, CellCept 500 mg powder for concentrate for solution for infusion, AT-1501 190 mg Vial, CellCept 250 mg capsules, Prograf 5 mg hard capsules

Primary endpoint: The mean estimated glomerular filtration rate (eGFR) at 12 months.
Endpoint(s): The rate of graft functional impairment at 12 months. A participant is considered to have graft functional impairment if they either: A) Have an eGFR <60 mL/min/1.73m2 or B) Have a decrease in eGFR ≥ 10 mL/min/1.73m2 from Month 1 to Month 12;, The rate of NODAT at 12 months post-transplant;, The rate of patient and graft survival at 12 months post-transplant. Patient and graft survival are defined as either A) Death, B) Re-transplantation or C) Requirement for regular dialysis;, Rate of BPAR-free patient and graft survival at 12 months post-transplant;, Rate of BPAR at 12 months.

Source: https://euclinicaltrials.eu/ctis-public/view/2023-503336-41-00